EU clinical trial 2024-519461-22-00: PHArmacoKinetics of methYLphenidate in adult patients with ADHD: comparison between patients with and without OBesity_PHACYLOB.
Protocol code: DR240305
Sponsor: Centre Hospitalier Regional Universitaire De Tours (Hospital/Clinic/Other health care facility). Phase: Therapeutic use (Phase IV). Countries: France (ongoing, recruiting).
Therapeutic area(s): Psychiatry and Psychology [F] - Mental Disorders [F03]; Diseases [C] - Nervous System Diseases [C10]; Psychiatry and Psychology [F] - Psychological Phenomena [F02]
Gender: Female, Male. Age: 18-64 years, 65+ years. Enrolment: 30.
Status: Ongoing, recruiting. Start date (EU): 2026-03-30. Decision date: 2025-04-28. Results received: No. Last updated: 2025-04-28.

Condition(s): Attention Deficit Disorder with or without Hyperactivity (ADHD) is a neurodevelopmental disorder characterized by disabling symptoms of inattention and/or hyperactivity-impulsivity beginning before the age of 12 with significant personal, social, academic and/or occupational impact (American Psychiatric Association 2013). This disorder, whose prevalence is around 5% in children and adolescents, affects 2.6% of adults (American Psychiatric Association 2013; Song et al. 2021).
Product: RITALINE L.P. 10 mg, gélule à libération prolongée

Primary endpoint: The primary endpoint was the area under the curve of blood concentrations of MPH and its active metabolite (alpha-phenyl 2-piperidine acid), as measured at different times after administration and up to 8 hours after MPH administration (comparison between patients with and without obesity): T0, T30 minutes, T1 hour, T2h, T3h, T4h, T7h, T8h.
Endpoint(s): Plasma concentrations of MPH and APP measured up to 8 hours (T0, T30 minutes, T1h, T2h, T3h, T4h, T6h, T8h) after MPH administration., Perceived effectiveness of MPH on attentional symptoms at these different times (visual analog scale, score from 1 to 7; Appendix 3)., Perceived effectiveness of MPH on hyperactivity/impulsivity symptoms at these different times (visual analog scale, score from 1 to 7; Appendix 3)., Correlation between MPH concentrations and perceived effectiveness of MPH on hyperactivity/impulsivity symptoms at these different times., Correlation between MPH concentrations and perceived effectiveness of MPH on inattention symptoms at these different times., Sociodemographic, medical and biological data (dates and times of sampling) for pharmacokinetic modeling: age, sex, weight, height (for BMI calculation), tobacco and alcohol consumption, morning breakfast intake, creatinine levels for eDFG calculation (CKD-EDI), blood count, complete liver work-up, initial severity of ADHD symptoms (Adult ADHD Self-Report Scale = ASRS-18, (Kessler et al. 2007))., Other individual psychological characteristics (baseline; Appendix 2): emotional dysregulation (total score on the Difficulties in Emotion Regulation Scale-36 items, Gratz & Roemer, 2004; French version: Dan-Glauser & Scherer, 2013), impulsivity (scores on each of the 5 dimensions of the UPPS-P French version: Billieux et al. 2012), bulimic hyperphagia (total score on the Binge Eating Scale, French version: Brunault et al. 2016).

Source: https://euclinicaltrials.eu/ctis-public/view/2024-519461-22-00